EU clinical trial 2024-516577-76-00: A phase I/II study to assess the safety, tolerability, pharmacokinetics, pharmacodynamics and efficacy of FR104, a novel antagonist pegylated anti-CD28 Fab’ antibody fragment in de novo renal transplant patients
Protocol code: RC20_0007
Sponsor: Centre Hospitalier Universitaire De Nantes (Hospital/Clinic/Other health care facility). Phase: Phase I and Phase II (Integrated)- Bioequivalence Study. Countries: France (ended).
Therapeutic area(s): Diseases [C] - Pathological Conditions, Signs and Symptoms [C23]
Gender: Female, Male. Age: 18-64 years, 65+ years. Enrolment: 10.
Status: Ended. Start date (EU): 2021-06-28. End date (EU): 2025-04-14. Decision date: 2024-08-14. Results received: No. Last updated: 2024-08-14.

Condition(s): Kidney transplant

Source: https://euclinicaltrials.eu/ctis-public/view/2024-516577-76-00